EU clinical trial 2024-513129-22-00: A Phase 3, Randomized, Double-Blind, Placebo-Controlled, Multicenter Study to Evaluate the Efficacy and Safety of Vosoritide in Children with Hypochondroplasia
Protocol code: 111-303
Sponsor: Biomarin Pharmaceutical Inc. (Pharmaceutical company). Phase: Therapeutic confirmatory (Phase III). Countries: Spain (ended), Germany (ended), Italy (ended), France (ended).
Therapeutic area(s): Diseases [C] - Congenital, Hereditary, and Neonatal Diseases and Abnormalities [C16]
Gender: Female, Male. Age: 0-17 years. Enrolment: 22.
Status: Ended. Start date (EU): 2024-12-17. End date (EU): 2026-04-23. End date: 2026-04-24. Decision date: 2024-09-16. Results received: No. Last updated: 2026-05-19.
Decision dates by country: DE: 2024-09-16, FR: 2024-09-19, IT: 2024-09-16, ES: 2024-09-17

Condition(s): Hypochondroplasia
Product: Voxzogo 1.2 mg powder and solvent for solution for injection, powder and solvent for solution for injection, Voxzogo 0.56 mg powder and solvent for solution for injection

Primary endpoint: Change from baseline in AGV at Week 52
Endpoint(s): Change from baseline in standing height at Week 52 versus placebo, Change from baseline in height Z-score at Week 52 versus placebo

Source: https://euclinicaltrials.eu/ctis-public/view/2024-513129-22-00